EU clinical trial 2024-516059-42-00: A Phase 1/2a, Open-Label, Non-Randomized, Dose-Escalation Study to Evaluate the Safety and Tolerability of GS030 in Subjects with Retinitis Pigmentosa.
Protocol code: GS030_CLIN_001
Sponsor: Gensight Biologics (Pharmaceutical company). Phase: Phase I and Phase II (Integrated)- Other. Countries: France (ongoing, recruiting).
Therapeutic area(s): Diseases [C] - Eye Diseases [C11]
Gender: Female, Male. Age: 18-64 years, 65+ years. Enrolment: 9.
Status: Ongoing, recruiting. Start date (EU): 2017-12-22. Decision date: 2024-08-13. Results received: No. Last updated: 2026-06-22.

Condition(s): Retinitis Pigmentosa
Product: GS030-DP, GS030-DP, GS030-DP

Primary endpoint: Safety and tolerability of GS030 treatment at Week 52/Year 1 based on local and systemic safety issues, specifically those related to IVT of GS030-DP and the subsequent repeated use of GS030-MD, as assessed by incidence of adverse events (AEs).
Endpoint(s): Assessment of the treatment effect on visual function, functional vision and mobility, with the change from baseline to Week 52 of parameters measured with FrACT, Humphrey visual field 102, full field threshold stimulus test (FST), Grating visual Acuity Test (GAT), square localization test and direction of motion test, door task, and line task, visual shape perception tests., Assessment of the treatment effect on structural changes of the posterior pole of the fundus from baseline to Week 52 with parameters measured with SD-OCT, color fundus photography, and fundus auto fluorescence (FAF)., Assessment of the treatment effect on QoL changes from baseline to Week 52 with the Visual Function Questionnaire-25 (VFQ-25) and ShortForm Survey 36 Version 2 (SF-36v2)., Humoral and cellular immune responses to rAAV2.7m8 and ChR-tdT protein.

Source: https://euclinicaltrials.eu/ctis-public/view/2024-516059-42-00